EU clinical trial 2023-505746-25-00: HOVON 169 CAD: Phase II trial of Zanubrutinib in primary Cold Agglutinin Disease. CaZa study
Protocol code: HOVON 169
Sponsor: Haemato Oncology Foundation For Adults Netherlands (Hospital/Clinic/Other health care facility). Phase: Therapeutic exploratory (Phase II). Countries: Netherlands (ongoing, recruitment ended), Belgium (ongoing, recruitment ended), Denmark (ongoing, recruitment ended), Norway (ongoing, recruitment ended).
Therapeutic area(s): Diseases [C] - Immune System Diseases [C20]
Gender: Female, Male. Age: 18-64 years, 65+ years. Enrolment: 26.
Status: Ongoing, recruitment ended. Start date (EU): 2024-07-16. Decision date: 2024-04-15. Results received: No. Last updated: 2026-08-07.
Decision dates by country: BE: 2024-04-16, DK: 2024-04-16, NO: 2024-04-18, NL: 2024-04-15

Condition(s): Cold agglutinin disease
Product: Zanubrutinib

Primary endpoint: CAD response rate (PR or CR) after 6 cycles of zanubrutinib treatment. Time of primary outcome assessment: at the end of cycle 6 (day 22-28) before starting cycle 7.
Endpoint(s): Rate of CAD response categories (CR, PR or none; separately) after 6 cycles of treatment and best CAD response on protocol, Time to CAD response, time to best CAD response and duration of CAD response., Hematological response after 6 cycles, best hematological response on protocol, time to hematological response and time to best hematological response and duration of hematological response., Change in IgM, M-protein, Hb and hemolytic parameters (bilirubin, LDH) after 6 cycles compared to baseline including median change and maximal change overall on protocol., Percentage of patients with cold-induced symptoms at baseline that achieve improvement or resolution of these symptoms after 6 cycles and overall on protocol., Time for patients with cold-induced symptoms at baseline to achieve improvement or resolution of these symptoms., Time to transfusion independence (in patients that are transfusion dependent at baseline)., Progression free survival at 6 months and 3 years, defined as time from registration to relapse of CAD or death from any cause, whichever comes first., Overall survival at 3 years, defined as time from registration to death from any cause., Toxicity as defined by type,frequency and severity of adverse events according to the NCI Common Terminology Criteria for Adverse Events version 5.0., Impact of zanubrutinib treatment on Quality of life and Fatigue measured as patient-reported outcomes (FACIT-Fatigue and EQ5D-5L questionnaires)

Source: https://euclinicaltrials.eu/ctis-public/view/2023-505746-25-00